EU clinical trial 2022-503081-74-00: A Phase 3, Open-label Study Evaluating the Long‑term Safety and Efficacy of Vanzacaftor/Tezacaftor/Deutivacaftor Triple Combination Therapy in Cystic Fibrosis Subjects 1 Year of Age and Older
Protocol code: VX22-121-106
Sponsor: Vertex Pharmaceuticals Inc. (Pharmaceutical company). Phase: Therapeutic confirmatory (Phase III). Countries: Germany (ongoing, recruiting), Sweden (ongoing, recruiting), Netherlands (ongoing, recruiting), France (ongoing, recruiting).
Therapeutic area(s): Diseases [C] - Respiratory Tract Diseases [C08]
Gender: Female, Male. Age: 0-17 years. Enrolment: 25.
Status: Ongoing, recruiting. Start date (EU): 2023-09-05. Decision date: 2023-06-16. Results received: No. Last updated: 2026-04-10.
Decision dates by country: SE: 2023-06-20, NL: 2023-07-17, DE: 2023-06-19, FR: 2023-06-19

Condition(s): Cystic Fibrosis
Product: VX-121/VX-661/VX-561 Film-coated tablet, Alyftrek 50 mg/20 mg/4 mg film-coated tablets, VX-121/VX-661/VX-561 granules, VX-121/VX-661/VX-561 Film-coated tablet, Alyftrek 125 mg/50 mg/10 mg film-coated tablets, VX-121/VX-661/VX-561 granules

Primary endpoint: Safety and tolerability of long-term treatment with VNZ/TEZ/D-IVA based on adverse events (AEs), clinical laboratory values, ECGs, vital signs, and pulse oximetry
Endpoint(s): Absolute change in SwCl, Absolute change in ppFEV1, Number of PEx and CF-related hospitalizations, Absolute change in CFQ-R RD score, Absolute change in BMI and BMI-for-age z score, Absolute change in weight and weight-for-age z score, Absolute change in height and height-for-age z score

Source: https://euclinicaltrials.eu/ctis-public/view/2022-503081-74-00